EU clinical trial 2023-504004-29-00: A Long-Term Follow-up Study to Evaluate the Safety and Efficacy of Adeno-Associated Virus (AAV) Serotype 8 (AAV8)-Mediated Gene Transfer of Glucose-6-Phosphatase (G6Pase) in Adults with Glycogen Storage Disease Type Ia (GSDIa)
Protocol code: 401GSDIA02
Sponsor: Ultragenyx Pharmaceutical Inc. (Pharmaceutical company). Phase: Phase I and Phase II (Integrated)- Other. Countries: Spain (ended), Netherlands (ended).
Therapeutic area(s): Diseases [C] - Nutritional and Metabolic Diseases [C18]
Gender: Female, Male. Age: 18-64 years, 65+ years. Enrolment: 3.
Status: Ended. Start date (EU): 2021-10-18. End date (EU): 2024-11-25. End date: 2025-02-25. Decision date: 2024-02-07. Results received: Yes. Last updated: 2025-01-06.
Decision dates by country: ES: 2024-02-07, NL: 2024-02-07

Condition(s): Glycogen storage disease type Ia
Product: Pariglasgene brecaparvovec

Primary endpoint: The incidence of AEs and SAEs for each cohort and overall assessed by severity and relationship to IP
Endpoint(s): The change from Day 0 (Study 401GSDIA01) in time to first hypoglycemic event during a controlled fasting challenge over time by cohort and overall, following IV administration of DTX401

Source: https://euclinicaltrials.eu/ctis-public/view/2023-504004-29-00